EU clinical trial 2024-514207-34-00: A prospective, randomized, placebo-controlled, double-blind, multicenter phase III registration clinical study to compare toripalimab (JS001) combined with lenvatinib versus placebo combined with lenvatinib as the 1st-line therapy for advanced hepatocellular carcinoma (HCC)
Protocol code: JS001-III-HCC-027
Sponsor: Shanghai Junshi Biosciences Co. Ltd. (Pharmaceutical company). Phase: Therapeutic confirmatory (Phase III). Countries: Poland (ongoing, recruitment ended), Italy (ongoing, recruitment ended).
Therapeutic area(s): Diseases [C] - Neoplasms [C04]
Gender: Female, Male. Age: 18-64 years, 65+ years. Enrolment: 22.
Status: Ongoing, recruitment ended. Start date (EU): 2021-07-08. Decision date: 2024-09-06. Results received: No. Last updated: 2026-07-02.
Decision dates by country: IT: 2024-09-17, PL: 2024-09-06

Condition(s): Advanced hepatocellular carcinoma (HCC)
Product: LENVIMA 4 mg hard capsules, Toripalimab Placebo, Toripalimab

Primary endpoint: Overall survival (OS)
Endpoint(s): Efficacy: 1. ORR, DOR, DCR, TTP and PFS evaluated per RECIST v1.1 and mRECIST. 2. Six-month and one-year PFS rate and one-year and two-year OS rate in both groups., Safety: 1. Incidence, severity and prognosis of adverse event (AE) and serious adverse event (SAE) judged in accordance with NCI-CTCAE v5.0; vital signs, ECG and abnormal laboratory examinations., PK and immunogenic parameters: 1. PK profile of toripalimab. 2. Analysis of anti-drug antibody (ADA) during treatment. 3. Immunogenicity of toripalimab: including incidence and titer of antidrug antibody (ADA), and the presence of neutralising antibody (Nab) in ADA-positive samples (if necessary)., Other study endpoints: 1. ORR, DOR, DCR, TTP and PFS evaluated by investigators using iRECIST criteria; 2. Correlation between PD-L1 expression level in tumor tissue, proportion of strong positive expression of PD-L1, tumor mutation burden (TMB) and the efficacy of toripalimab combined with lenvatinib

Source: https://euclinicaltrials.eu/ctis-public/view/2024-514207-34-00